EU clinical trial 2023-509765-20-00: Assessment of Pharmacokinetic Similarity of FYB206 in Comparison with Keytruda in Resected Stage II or Stage III Melanoma Patients
Protocol code: FYB206-C1-01
Sponsor: Formycon AG (Pharmaceutical company). Phase: Human Pharmacology (Phase I)- Bioequivalence Study. Countries: Lithuania (ended), Romania (ended), Poland (ended), Bulgaria (ended), Estonia (ended).
Therapeutic area(s): Diseases [C] - Neoplasms [C04]; Diseases [C] - Skin and Connective Tissue Diseases [C17]
Gender: Female, Male. Age: 18-64 years, 65+ years. Enrolment: 116.
Status: Ended. Start date (EU): 2024-10-21. End date (EU): 2026-07-07. End date: 2026-07-08. Decision date: 2024-08-28. Results received: No. Last updated: 2026-02-13.
Decision dates by country: EE: 2024-11-19, LT: 2024-08-28, PL: 2024-08-30, RO: 2024-09-02, BG: 2024-09-02

Condition(s): Melanoma: Adjuvant treatment of patients with Stage IIB, IIC, or III melanoma following complete resection

Source: https://euclinicaltrials.eu/ctis-public/view/2023-509765-20-00